EU clinical trial 2024-519899-72-00: A Double-Blind, Randomized, Placebo-Controlled, Phase 1b Study to Assess the Safety, Tolerability, and Pharmacokinetics of Multiple Ascending Doses of THN391 in Early Alzheimer’s Disease Subjects
Protocol code: THN391-NEU-102
Sponsor: Therini Bio Inc. (Laboratory/Research/Testing facility). Phase: Human Pharmacology (Phase I)- Other. Countries: Netherlands (ongoing, recruitment ended).
Therapeutic area(s): Diseases [C] - Nervous System Diseases [C10]
Gender: Female, Male. Age: 18-64 years, 65+ years. Enrolment: 12.
Status: Ongoing, recruitment ended. Start date (EU): 2025-05-08. Decision date: 2025-04-14. Results received: No. Last updated: 2026-05-27.

Condition(s): Alzheimer's Disease

Source: https://euclinicaltrials.eu/ctis-public/view/2024-519899-72-00